EU clinical trial 2023-509452-34-00: A Phase IIa Open Label, Dose-Finding, Clinical Trial to Evaluate Safety, Tolerability and Preliminary Efficacy of Etrinabdione in Patients with Peripheral Arterial Disease (PAD). CLAUDIA Trial
Protocol code: 2023-509452-34-00
Sponsor: Vivacell Biotechnology Espana S.L. (Pharmaceutical company). Phase: Therapeutic exploratory (Phase II). Countries: Spain (ended).
Therapeutic area(s): Diseases [C] - Cardiovascular Diseases [C14]
Gender: Female, Male. Age: 18-64 years, 65+ years. Enrolment: 30.
Status: Ended. End date (EU): 2026-05-19. Decision date: 2024-05-13. Results received: No. Last updated: 2025-12-18.

Condition(s): Peripheral Arterial Disease
Product: Etrinabdione oral solution

Primary endpoint: Incidence and severity of treatment-emergent adverse events (TEAEs) from baseline to the end of the study
Endpoint(s): Changes from baseline for Vascularization: Angio-CT, Changes from baseline for Hemodynamic: ankle/brachial Index, Changes from baseline for Stenosis: doppler ultrasound, Changes from baseline for Quality of life: VascuQoL-6 questionnaire, Changes from baseline for Tissue oxygenation: transcutaneous oximetry (TcPO2), Changes from baseline for Etrinabdione plasma levels (pre-dose and 3 hours post dose) at Day 1 and months 1, 3, 6,12, and EOS, Changes from baseline for selected drug and/or disease-related vascular and inflammatory biomarkers at Day 1 and months 1, 3, 6, 12, and EOS, Changes from baseline for: Clinical improvement: absolute claudication time

Source: https://euclinicaltrials.eu/ctis-public/view/2023-509452-34-00